EU clinical trial 2022-500109-41-00: OPTIMISE: Optimized Immunosuppression for Corneal Transplantation: a multi-centre randomized controlled clinical trial
Sponsor: University Hospital Maastricht (Hospital/Clinic/Other health care facility). Phase: Therapeutic use (Phase IV). Countries: Netherlands (ongoing, recruiting), Germany (ongoing, recruiting).
Therapeutic area(s): Diseases [C] - Eye Diseases [C11]
Gender: Female, Male. Age: 18-64 years, 65+ years. Enrolment: 442.
Status: Ongoing, recruiting. Start date (EU): 2024-07-29. Decision date: 2022-06-30. Results received: No. Last updated: 2026-02-02.
Decision dates by country: DE: 2023-10-30, NL: 2022-06-30

Condition(s): Corneal transplantation, Descemet's Membrane Endothelial Keratoplasty (DMEK)
Product: FML Liquifilm 0.1% w/v Sterile Eye Drops Suspension, Dexamethason 1 mg/ml Teva, oogdruppels

Primary endpoint: Step I (Year 1): The primary outcome of Step I, IOP elevation, is the development of IOP elevation, defined as an IOP ≥24 mmHg or an increase of ≥10 mmHg compared to preoperative baseline at any postoperative examination., Step II (Year 2): The primary outcome of Step II is the Endothelial Cell Loss (ECL) in the second year. This will be calculated based on specular microscopy images of the central cornea taken at 12 months and 24 months post-operatively
Endpoint(s): Rejection-free graft survival, Short-term trial-based economic evaluation (TBEE, cost-effectiveness analyses), Life-long model-based economic evaluation (MBEE, cost-effectiveness analyses), Patient-reported outcome measures (PROMs): vision-specific and generic health-related quality of life, patient experiences and satisfaction, and compliance, Best-corrected distance visual acuity (BCDVA), Structural outcomes: corneal, central macular, and retinal nerve fiber layer thickness

Source: https://euclinicaltrials.eu/ctis-public/view/2022-500109-41-00